EU clinical trial 2024-511821-75-00: Dose escalation of allogeneic Adipose derived Stroma/stem Cells for the treatment of Crohn’s fistula
Protocol code: RC31/13/7030
Sponsor: Centre Hospitalier Universitaire De Toulouse (Hospital/Clinic/Other health care facility). Phase: Phase I and Phase II (Integrated)- First administration to humans. Countries: France (ongoing, recruiting).
Therapeutic area(s): Diseases [C] - Digestive System Diseases [C06]
Gender: Female, Male. Age: 18-64 years, 65+ years. Enrolment: 9.
Status: Ongoing, recruiting. Start date (EU): 2025-03-13. Decision date: 2024-09-12. Results received: No. Last updated: 2026-02-02.

Condition(s): Crohn’s fistula

Source: https://euclinicaltrials.eu/ctis-public/view/2024-511821-75-00